EU clinical trial 2024-519895-23-00: Treatment of Early Borderline Lesions in Low Immunological Risk Kidney Transplant Patients: a Spanish Multicenter, Randomized, Controlled Parallel-group Trial: The TRAINING Study
Sponsor: Fundacion Canaria Instituto De Investigacion Sanitaria De Canarias (Patient organisation/association). Phase: Phase II and Phase III (Integrated). Countries: Spain (authorised, recruitment pending).
Therapeutic area(s): Not possible to specify
Gender: Female, Male. Age: 18-64 years, 65+ years. Enrolment: 80.
Status: Authorised, recruitment pending. Decision date: 2025-01-29. Results received: No. Last updated: 2025-01-29.

Condition(s): To analyze whether the anti-rejection treatment of borderline lesions can modify the expression and klotho levels, as well as proinflammatory cytokines that regulate klotho expression at both years post-transplant., Know in a controlled and randomized clinical trial, carried out in low-risk patients immunological and stable renal function, if the treatment of BL lesions, detected in the third month post-transplant, with rabbit polyclonal antilymphocytic globulin prevents or slows the progression of chronic histological lesions of the graft (FIAT) and the deterioration of its function compared to clinical follow-up conventional, after two years of post-transplant follow-up.
Product: Grafalon 20 mg/ml concentrato per soluzione per infusione

Primary endpoint: Presence of Interstitial Fibrosis and Tubular Atrophy (FIAT) and calculated renal function of the graft with CKD-EPI at 24 months of the study in both therapeutic arms.
Endpoint(s): Patient and graft survival. • Rate of clinical and biopsy-confirmed acute rejection, and proteinuria at 3, 6, 12 and 24 months. • Blood pressure figures and number of hypotensive agents, lipid levels and need for lipid-lowering, and weight and BMI increase. • Rate of post-transplant diabetes (PTDM) or glucose intolerance at one year and the second year of transplantation according to ADA criteria. • Adherence to immunosuppressive treatment evaluated using the Basel scale.

Source: https://euclinicaltrials.eu/ctis-public/view/2024-519895-23-00